EU clinical trial 2024-519011-34-00: A clinical study to investigate the antibacterial efficacy of arbutin metabolites in urine.
Protocol code: SB-CYS 0124
Sponsor: Schaper & Bruemmer GmbH & Co. KG (Pharmaceutical company). Phase: Human Pharmacology (Phase I)- Other. Countries: Germany (ongoing, recruitment ended).
Therapeutic area(s): Diseases [C] - Bacterial Infections and Mycoses [C01]; Diseases [C] - Female Urogenital Diseases and Pregnancy Complications [C13]
Gender: Female. Age: 18-64 years. Enrolment: 14.
Status: Ongoing, recruitment ended. Start date (EU): 2025-08-04. Decision date: 2025-07-14. Results received: No. Last updated: 2025-07-14.

Condition(s): Urinary Tract Infection

Source: https://euclinicaltrials.eu/ctis-public/view/2024-519011-34-00